EU clinical trial 2023-506486-60-01: DAPARHT: DAPAgliflozin for Renal protection in Heart Transplant recipients
Protocol code: D1699L00015
Sponsor: Oslo University Hospital HF (Hospital/Clinic/Other health care facility). Phase: Therapeutic confirmatory (Phase III). Countries: Netherlands (ongoing, recruitment ended), Norway (ongoing, recruitment ended), Sweden (ongoing, recruitment ended).
Therapeutic area(s): Diseases [C] - Cardiovascular Diseases [C14]
Gender: Female, Male. Age: 18-64 years, 65+ years. Enrolment: 270.
Status: Ongoing, recruitment ended. Start date (EU): 2022-04-26. Decision date: 2023-10-17. Results received: No. Last updated: 2025-04-08.
Decision dates by country: NO: 2023-10-27, SE: 2024-09-11, NL: 2023-10-17

Condition(s): Heart transplant, Kidney failure
Product: Placebo for dapagliflozin film-coated tablets 10 mg, DAPAGLIFLOZIN

Primary endpoint: The primary endpoint will be the slope of the eGFR from 2 weeks to end-of-treatment (12 months), calculated as the difference in eGFR from two weeks to 12 months after start of the intervention. The eGFR is calculated from serum creatinine using the Modification of Diet in Renal Disease (MDRD) formula
Endpoint(s): Baseline-adjusted body weight, The change in the albumin / creatinine ratio in the urine from baseline to end-of-treatment in patients with a baseline ratio > 30 mg/g at baseline, The change in the blood level of glycated haemoglobin (HbA1c) in patients with diabetes mellitus, Change in body composition (exploratory endpoint), Biomarkers of renal damage (i.e. Cystatin-C, Lipocalin (NGAL), KIM-1, osteopontin) (exploratory endpoints)

Source: https://euclinicaltrials.eu/ctis-public/view/2023-506486-60-01